EU clinical trial 2024-516833-11-00: Phase I clinical trial to evaluate the pharmacokinetics, safety and tolerability of repeated topical application of PARENTIDE in healthy volunteers
Protocol code: MOB-00
Sponsor: Bcn Peptides S.A. (Pharmaceutical company). Phase: Human Pharmacology (Phase I)- Other. Countries: Spain (ended).
Therapeutic area(s): Not possible to specify
Gender: Female, Male. Age: 18-64 years, 65+ years. Enrolment: 6.
Status: Ended. Start date (EU): 2025-03-12. End date (EU): 2025-03-31. Decision date: 2025-02-24. Results received: No. Last updated: 2025-02-24.

Condition(s): Healthy volunteers

Source: https://euclinicaltrials.eu/ctis-public/view/2024-516833-11-00